EU clinical trial 2024-511153-21-00: Effects of goal-directed fluid management guided by a non-invasive device on the incidence of postoperative complications in neurosurgery: a multicenter, prospective, randomized, controlled study
Protocol code: NCHGDT
Sponsor: Fakultni Nemocnice Brno (Hospital/Clinic/Other health care facility). Phase: Therapeutic use (Phase IV). Countries: Czechia (ongoing, recruiting).
Therapeutic area(s): Analytical,Diagnostic,Therapeutic Techniques and Equipment [E]-Surgical Procedures, Operative [E04]; Diseases [C] - Nervous System Diseases [C10]
Gender: Female, Male. Age: 18-64 years, 65+ years. Enrolment: 140.
Status: Ongoing, recruiting. Start date (EU): 2025-11-27. Decision date: 2024-06-11. Results received: No. Last updated: 2026-05-18.

Condition(s): elective neurosurgery treating unspecified brain conditions
Product: Isolyte infuzní roztok

Primary endpoint: Incidence of adverse events and reactions according to following Adverse Events of Special Interest (AESI) in both study groups.
Endpoint(s): Duration of surgery, LOS, ICU LOS, 28-day mortality, descriptive analysis of the incidence of any adverse events and reactions, MAP, HR, SVV, number of episodes of hypotension, number of vasopressor administrations, Hemoglobin, plasma lactate level, Volume of blood loss, urinary output, number of administered units of packed RBC, number of subjects receiving transfusion, crystalloid and colloid solutions consumption, boluses of crystalloids

Source: https://euclinicaltrials.eu/ctis-public/view/2024-511153-21-00